EU clinical trial 2024-514756-32-00: SARCOME 09_Intergroup Study (SFCE/GSF-GETO) OS2006 - Zoledronate Osteosarcoma Treatment Protocol for osteosarcoma of the child, adolescent and adult including: - A randomized trial - And biological studies.
Protocol code: UC-0150/ 0603
Sponsor: Unicancer (Hospital/Clinic/Other health care facility). Phase: Therapeutic confirmatory (Phase III). Countries: France (ongoing, recruitment ended).
Therapeutic area(s): Diseases [C] - Neoplasms [C04]
Gender: Female, Male. Age: 0-17 years, 18-64 years, 65+ years. Enrolment: 653.
Status: Ongoing, recruitment ended. Start date (EU): 2007-03-19. Decision date: 2024-08-12. Results received: No. Last updated: 2024-08-12.

Condition(s): High grade osteosarcoma
Product: Zometa 4 mg/100 ml solution for infusion

Primary endpoint: Event-free survival at 3 years.
Endpoint(s): Overall survival,, Histological response,, Short-term (NCI-CTC v3) and long-term toxicity,, Bone metabolism,, Quality of life.

Source: https://euclinicaltrials.eu/ctis-public/view/2024-514756-32-00